EU clinical trial 2023-505904-41-00: An Open-label Extension Trial to Evaluate the Long-term Safety of KVD900, an Oral Plasma Kallikrein Inhibitor, for On-demand Treatment of Angioedema Attacks in Adolescent and Adult Patients with Hereditary Angioedema Type I or II; A Pharmacokinetic Subtrial in Adolescent Patients with Hereditary Angioedema Type I or II Participating in the KVD900-302 Trial
Protocol code: KVD900-302
Sponsor: Kalvista Pharmaceuticals Limited (Pharmaceutical company). Phase: Therapeutic confirmatory (Phase III). Countries: Slovakia (ended), Netherlands (ended), Italy (ended), Bulgaria (ended), Hungary (ended), Austria (ended), Germany (ended), Greece (ended), Poland (ended), Romania (ended), France (ended), Spain (ended), Portugal (ended).
Therapeutic area(s): Diseases [C] - Hemic and Lymphatic Diseases [C15]
Gender: Female, Male. Age: 0-17 years, 18-64 years, 65+ years. Enrolment: 75.
Status: Ended. Start date (EU): 2022-11-17. End date (EU): 2026-05-27. End date: 2026-05-28. Decision date: 2024-02-26. Results received: No. Last updated: 2026-02-06.
Decision dates by country: AT: 2024-02-27, IT: 2024-03-04, PT: 2024-02-26, ES: 2024-02-26, RO: 2024-03-04, HU: 2024-02-27, BG: 2024-02-26, NL: 2024-02-26, GR: 2024-03-04, PL: 2024-02-29, SK: 2024-02-26, FR: 2024-03-01, DE: 2024-02-29

Condition(s): Hereditary Angioedema Type I or II
Product: KVD900, KVD900

Primary endpoint: Frequencies and percentages of patients with AEs, AEs within 2 days of IMP administration, serious AEs, and AEs causing premature discontinuation, Number and percentage of patients with normal or abnormal laboratory results at each scheduled visit, Number and percentage of patients with normal or abnormal vital sign results at each scheduled visit
Endpoint(s): PGI-C: time to beginning of symptom relief defined as at least '' a little better'' (2 time points in a row) within 12 hours of initial dose of IMP administration., PGI-S: time to first incidence of 2 time points in a row decrease from baseline within 12 hours of initial dose of IMP administration., PGI-S: time to HAE attack resolution defined as ''none'' within 24 hours of initial dose of IMP administration.

Source: https://euclinicaltrials.eu/ctis-public/view/2023-505904-41-00